EU clinical trial 2025-522372-93-00: A modular Phase I/II, open-label, multi-center study to evaluate the safety, tolerability, pharmacokinetics, immunogenicity, and preliminary efficacy of AZD4512 monotherapy or in combination with anticancer agent(s) in participants with Acute Lymphoblastic Leukemia
Protocol code: ALLight D9891C00001
Sponsor: AstraZeneca AB (Pharmaceutical company). Phase: Phase I and Phase II (Integrated)- First administration to humans. Countries: Spain (ongoing, recruiting).
Therapeutic area(s): Diseases [C] - Hemic and Lymphatic Diseases [C15]
Gender: Female, Male. Age: 0-17 years, 18-64 years, 65+ years. Enrolment: 13.
Status: Ongoing, recruiting. Start date (EU): 2026-01-13. Decision date: 2025-11-24. Results received: No. Last updated: 2026-05-26.

Condition(s): B-cell acute lymphoblastic leukemia (B-ALL)
Product: AZD4512

Primary endpoint: Module 1 Dose Escalation: Safety and Tolerability of AZD4512 -Assessment of DLT -Assessment of TEAEs/TRAEs/SAEs -Interruptions, modifications, delays and discontinuations -Clinically significant changes from baseline, Module 1 Dose Escalation: Determine the MTD and/or doses to explore in Module 2, Module 2 Dose Optimization: Antitumour activity and determine the RP2D of AZD4512 -Response Rate: ORR (CR/CRh), Module 2 Dose Optimization:Safety and Tolerability of AZD4512 -Assessment of TEAEs/TRAEs/SAEs -Interruptions, modifications, delays and discontinuations -Clinically significant changes from baseline
Endpoint(s): Module 1 Dose Escalation: Characterize AZD4512 PK as monotherapy, Module 1 Dose Escalation: Immunogenicity as monotherapy -ADA development, Module 1 Dose Escalation: Preliminary Antitumour Activity of AZD4512 -Response Rate: ORR (CR/CRh), CR and CRc rate, TTR, DoR, EFS, OS, subsequent HSCT, Module 2 Dose Optimization: Antitumour Activity of AZD4512 -Response Rate: CR and CRc rate, TTR, DoR, EFS, OS, subsequent HSCT, Module 2 Dose Optimization: Effect of AZD4512 on MRD (NGS) -MRD-negative CR rate, CR/CRh (ORR), CRc (CR/CRi/CRh) rate, Module 2 Dose Optimization: PK of AZD4512 as monotherapy, Module 2 Dose Optimization: Immunogenicity as monotherapy -ADA development

Source: https://euclinicaltrials.eu/ctis-public/view/2025-522372-93-00